EU clinical trial 2024-518580-35-00: TARGETing steroid withdrawal in SLE (TARGET2020 STUDY): a pragmatic, randomized, phase IV, open-label, non-inferiority trial
Protocol code: TARGET2020
Sponsor: Azienda Ospedaliero Universitaria Pisana (Hospital/Clinic/Other health care facility). Phase: Therapeutic use (Phase IV). Countries: Italy (authorised, recruiting).
Therapeutic area(s): Diseases [C] - Immune System Diseases [C20]
Gender: Female, Male. Age: 18-64 years, 65+ years. Enrolment: 252.
Status: Authorised, recruiting. Start date (EU): 2024-11-20. Decision date: 2024-11-19. Results received: No. Last updated: 2025-11-19.

Condition(s): Systemic Lupus Erythematosus
Product: Prednisone Mylan Pharma 5 mg compresse, Prednisone Mylan Pharma 5 mg compresse

Primary endpoint: Proportion of patients maintaining modified LLDAS for 100% of the follow-up period (36 months) even after glucocorticoid withdrawal
Endpoint(s): o Proportion of patients who maintain modified LLDAS for 100% of the visits at 12, 24 and 36 months o Proportion of patients who maintain remission on treatment for 100% of the visits at 12, 24 and 36 months

Source: https://euclinicaltrials.eu/ctis-public/view/2024-518580-35-00